EU clinical trial 2025-524302-15-00: A Multicentre, Open-Label Study Evaluating the Safety, Tolerability and Efficacy of MaaT013 in Ruxolitinib-Refractory or Intolerant Paediatric and Adolescent participants with Gastrointestinal Acute Graft-versus-Host Disease
Protocol code: MPOH14
Sponsor: MaaT PHARMA (Pharmaceutical company). Phase: Therapeutic exploratory (Phase II). Countries: Netherlands (authorised, recruitment pending), Italy (authorised, recruitment pending), France (authorised, recruitment pending), Spain (authorised, recruitment pending).
Therapeutic area(s): Diseases [C] - Digestive System Diseases [C06]
Gender: Female, Male. Age: 0-17 years, 18-64 years. Enrolment: 18.
Status: Authorised, recruitment pending. Decision date: 2026-04-17. Results received: No. Last updated: 2026-04-22.
Decision dates by country: FR: 2026-04-17, IT: 2026-04-22, ES: 2026-04-21, NL: 2026-04-21

Condition(s): Gastrointestinal Acute Graft-versus-Host Disease (GI-aGvHD)
Product: VANCOMYCIN, MaaT013

Primary endpoint: Co-primary: From inclusion to Month 6 (M6): Incidence of all AEs treatment-emergent AEs (TEAEs), serious AEs (SAEs), and assessment of all safety parameters (physical examinations, vital signs and laboratory clinically significant abnormalities)., Co-Primary: From M6 to M12, incidence of SAEs and AESIs only., Co-Primary: A comprehensive and detailed analysis of the nature, severity and frequency of AEs and SAEs will be performed., Co-Primary: 1) Retention time ▪ Proportion of participants able to retain MaaT013 for at least 30 min. ▪ Proportion of participants able to retain MaaT013 for at least 1h. ▪ Proportion of participants able to retain MaaT013 for at least 2h., Co-Primary: 2) Stress/anxiety evaluated with the depression anxiety stress scale, Co-Primary: 3) Procedure-related AEs ▪ Solicited TEAEs related to administration procedure will be collected within 72h after each MaaT013 administration, Co-Primary: 4) Factors compromising the administration of the study drug ▪ TEAEs leading to treatment discontinuation, interruption and postponement will be collected.
Endpoint(s): Proportion of participants achieving complete response (CR), very good partial response (VGPR) or partial response (PR) for GI at D28, D56, M3, M6 and M12 assessed by IRC and investigator, without requirement for additional systemic therapies prior to the assessment time point., Proportion of participants achieving CR, VGPR or PR for all organs at D28, D56, M3, M6 and M12 assessed by IRC and investigator, without requirement for additional systemic therapies prior to the assessment time point., DOR is assessed for responders only and is defined as the time from first response (at least PR) until aGvHD progression (loss of at least PR compared to baseline, confirmed with 2 evaluations), or the starting date of additional systemic therapies for aGvHD. Onset of cGvHD, or death without prior observation of aGvHD progression are considered as competing risks. DOR will be evaluated for both GI and overall aGvHD, until M12., OS is defined as the time from the date of first MaaT013 administration to the date of death due to any cause., PFS is defined as the time from first MaaT013 administration to the date of underlying malignancy relapse, progression or death (all causes). PFS will be evaluated up to M12., TTP is defined as the time from first MaaT013 administration to the date of underlying malignancy relapse or progression. TTP will be evaluated up to M12., SFR is defined as the number and percentage of participants who are steroid-free, defined by a daily dose of CS ≤ 0.25 mg/kg/day (methylprednisolone equivalent dose). Steroid-free rate at D28, D56, M3, M6, and M12 will be provided. SFR will be evaluated up to M12., Cumulative total dose of CS in mg/kg from date of first MaaT013 administration to D28, D56, M3, M6, and M12 will be derived and summarized., Number and percentage of participants who definitively tapered off CS at M12., Proportion of participants with cGvHD, defined as the diagnosis of any cGvHD, including mild, moderate or severe, up to M12 (NIH criteria).

Source: https://euclinicaltrials.eu/ctis-public/view/2025-524302-15-00